EU clinical trial 2024-511951-16-00: Phase IV, Randomized, Multicenter, Double-Blind Clinical Trial Designed to Evaluate the Safety and Appropriateness of Switching from DTG/3TC to BIC/FTC/TAF in People With HIV, Good Virological Control, and Neuropsychiatric Vulnerabilities: MIND Study
Protocol code: GESIDA 11920
Sponsor: Fundacion Seimc Gesida (Laboratory/Research/Testing facility). Phase: Therapeutic use (Phase IV). Countries: Spain (ended).
Therapeutic area(s): Diseases [C] - Virus Diseases [C02]
Gender: Female, Male. Age: 18-64 years. Enrolment: 84.
Status: Ended. Start date (EU): 2022-08-30. End date (EU): 2024-08-07. Decision date: 2024-05-13. Results received: Yes. Last updated: 2024-05-13.

Condition(s): HIV
Product: Biktarvy 50 mg/200 mg/25 mg film-coated tablets, Biktarvy 50 mg/200 mg/25 mg film-coated tablets, Dovato 50 mg/300 mg film-coated tablets, Dovato 50 mg/300 mg film-coated tablets, Biktarvy 50 mg/200 mg/25 mg film-coated tablets, Biktarvy 50 mg/200 mg/25 mg film-coated tablets, Dovato 50 mg/300 mg film-coated tablets, Biktarvy 50 mg/200 mg/25 mg film-coated tablets, Biktarvy 50 mg/200 mg/25 mg film-coated tablets, Dovato 50 mg/300 mg film-coated tablets, Biktarvy 50 mg/200 mg/25 mg film-coated tablets, Biktarvy 50 mg/200 mg/25 mg film-coated tablets

Primary endpoint: Proportion of neuropsychiatric adverse effects grade 2-4 (defined using the AIDS Clinical Trials Group Adverse Events Grading Score11)
Endpoint(s): Proportion of grade 2-4 adverse effects (defined using the AIDS Clinical Trials Group Adverse Events Grading Score11), Proportion of ART discontinuations due to neuropsychiatric adverse effects., Proportion of ART discontinuations for any reason.

Source: https://euclinicaltrials.eu/ctis-public/view/2024-511951-16-00